EU clinical trial 2023-505455-44-00: A Phase 1b/2, Multicenter, Open-label Basket Study Evaluating the Safety and Efficacy of Bemarituzumab Monotherapy in Solid Tumors with FGFR2b Overexpression (FORTITUDE-301)
Protocol code: 20210104
Sponsor: Amgen Inc. (Pharmaceutical company). Phase: Phase I and Phase II (Integrated)- Other. Countries: France (ended), Hungary (ended), Romania (ended), Spain (ended), Netherlands (ended), Finland (ended), Portugal (ended), Belgium (ended), Denmark (ended), Austria (ended), Bulgaria (ended), Czechia (ended), Greece (ended), Poland (ended), Italy (ended).
Therapeutic area(s): Diseases [C] - Neoplasms [C04]
Gender: Female, Male. Age: 18-64 years, 65+ years. Enrolment: 300.
Status: Ended. Start date (EU): 2022-06-29. End date (EU): 2026-01-28. End date: 2026-01-29. Decision date: 2024-09-17. Results received: No. Last updated: 2025-07-17.
Decision dates by country: RO: 2024-09-23, PT: 2024-09-17, CZ: 2024-09-19, AT: 2024-09-22, GR: 2024-09-20, BG: 2024-09-17, FI: 2024-09-17, PL: 2024-09-30, BE: 2024-09-17, NL: 2024-09-17, FR: 2024-09-19, DK: 2024-09-20, IT: 2024-10-07, HU: 2024-09-18, ES: 2024-09-18

Condition(s): Solid tumours
Product: Bemarituzumab

Primary endpoint: Phase 1b: Dose-limiting toxicities (DLTs), treatment-emergent adverse events, treatment-related adverse events, and clinically significant changes in vital signs, visual acuity, and clinical laboratory tests, Phase 2: Objective response (OR) (OR = complete response [CR] + partial response [PR]), measured by computed tomography (CT) or magnetic resonance imaging (MRI) as determined by investigator per Response Evaluation Criteria in Solid Tumors version 1.1 (RECIST v1.1)
Endpoint(s): Phase 1b: Objective response (OR), Phase 1b and 2: Disease control (DC) (CR, PR, or stable disease [SD]), Phase 1b and 2: Time to response (TTR), Phase 1b and 2: Overall survival (OS), Phase 1b: PK parameters for bemarituzumab including, but not limited to, area under the concentration time curve (AUC), maximum observed serum concentration (Cmax), and the observed concentration at the end of a dose interval (Ctrough), Phase 2: PK parameters for bemarituzumab including, but not limited to, AUC, Cmax, and Ctrough, Phase 2: Treatment-emergent adverse events, treatment-related adverse events, and clinically significant changes in vital signs, visual acuity, and clinical laboratory tests, Phase 1b and 2: Duration of response (DOR), Phase 1b and 2: Progression-free survival (PFS)

Source: https://euclinicaltrials.eu/ctis-public/view/2023-505455-44-00